EU clinical trial 2024-514644-93-00: Strategic treatment Pause of first-line Immune Check point inhibitor + Inhibitor in good or only one adverse prognostic factor in intermediate risk metastatic renal cell carcinoma (mRCC) with an objective response: a randomized, non-inferiority phase III study - SPICI
Protocol code: CHUBX 2021/08
Sponsor: Centre Hospitalier Universitaire De Bordeaux (Hospital/Clinic/Other health care facility). Phase: Therapeutic confirmatory (Phase III). Countries: France (ongoing, recruitment ended).
Therapeutic area(s): Diseases [C] - Neoplasms [C04]
Gender: Female, Male. Age: 18-64 years, 65+ years. Enrolment: 372.
Status: Ongoing, recruitment ended. Start date (EU): 2022-12-09. Decision date: 2024-07-17. Results received: No. Last updated: 2025-05-27.

Condition(s): Metastatic renal cell carcinoma (mRCC) with a good or only one adverse prognostic factor intermediate risk per IMDC score
Product: KEYTRUDA 25 mg/mL concentrate for solution for infusion, Inlyta 5 mg film-coated tablets, Kisplyx 10 mg hard capsules, CABOMETYX 20 mg film-coated tablets, OPDIVO 10 mg/mL concentrate for solution for infusion.

Primary endpoint: Percentage of participants without progression at up to 12 months after randomisation, based on a blinded independent central review (BICR) according to RECIST v1.1 criteria
Endpoint(s): Proportion of participants who experience an adverse event or serious adverse event, and mean number of adverse events or serious adverse events up to 12 months after randomisation, Mean change in quality of life up to 12 months after randomisation, measured by the Functional Assessment of Cancer Therapy-Kidney Symptom Index (FKSI-19), Mean scores in the Hospital Anxiety and Depression Scale at up to 12 months after randomisation, Quality-adjusted time without symptoms of disease or toxicity (Q-TWiST), 2-year overall survival, 2-year progression-free survival, For patients in the experimental arm, site and distribution of the sites of progression: known lesions, new lesion(s) or both, For patients in the experimental arm, distribution of treatment modality after progression: surveillance, focal treatment or general treatment, For patients in the experimental arm, if general treatment when restarting PD-1/PD-L1 ICI + VEGFR-TKI, percentage of patients with status SD or in objective response at 6 months, In France only, healthcare resource utilisation up to 12 months after randomisation, measured by medication use and hospitalisations

Source: https://euclinicaltrials.eu/ctis-public/view/2024-514644-93-00